EU clinical trial 2024-517545-13-00: A Phase IIIb/IV, Multicenter, Randomized, Open-Label, Two-Arm Study to Investigate the Efficacy, Safety, and Durability of Faricimab Administered up to Every 24 Weeks in Patients with Neovascular Age-Related Macular Degeneration (CONSTANCE)
Protocol code: MR45638
Sponsor: F. Hoffmann-La Roche AG (Pharmaceutical company). Phase: Phase III and phase IV (Integrated). Countries: Germany (ongoing, recruitment ended), Italy (ongoing, recruiting), Spain (ongoing, recruitment ended), France (authorised, recruitment pending).
Therapeutic area(s): Diseases [C] - Eye Diseases [C11]
Gender: Female, Male. Age: 18-64 years, 65+ years. Enrolment: 89.
Start date (EU): 2025-06-04. Decision date: 2025-06-03. Results received: No. Last updated: 2026-01-21.
Decision dates by country: IT: 2025-06-03, ES: 2025-06-04, FR: 2025-07-14, DE: 2025-06-02

Condition(s): Neovascular Age-Related Macular Degeneration
Product: Vabysmo 120 mg/mL solution for injection

Primary endpoint: Change from baseline in BCVA score as measured using the ETDRS VA chart at a starting distance of 4 meters
Endpoint(s): Change from baseline in BCVA averaged over Weeks 92, 96, and 100, Change from baseline in BCVA over time, Change from baseline in central subfield thickness (CST) averaged over Weeks 44, 48, and 52, Change from baseline in CST averaged over Weeks 92, 96, and 100, Change from baseline in CST over time, Proportion of participants on a Q4W, Q8W, Q12W, Q16W, Q20W, and Q24W treatment interval at Weeks 52 and 100, Incidence and severity of ocular adverse events, Incidence and severity of non-ocular adverse events

Source: https://euclinicaltrials.eu/ctis-public/view/2024-517545-13-00